EU clinical trial 2024-517187-36-01: A Phase II/III Multicenter Randomized, Double-Blind, Placebo-Controlled, Two-Stage Adaptive Design, Platform Trial of Investigational Treatments for Primary Prevention of Disease Progression in Dominantly Inherited Alzheimer’s Disease
Protocol code: DIAN-TU-002
Sponsor: Washington University School Of Medicine (Educational Institution). Phase: Phase II and Phase III (Integrated). Countries: Spain (ongoing, recruiting), France (authorised, recruitment pending), Germany (authorised, recruiting), Italy (authorised, recruiting), Netherlands (not authorised).
Therapeutic area(s): Diseases [C] - Nervous System Diseases [C10]
Gender: Female, Male. Age: 18-64 years, 65+ years. Enrolment: 27.
Start date (EU): 2026-06-24. Decision date: 2025-06-30. Results received: No. Last updated: 2026-07-13.
Decision dates by country: IT: 2025-10-16, ES: 2025-06-30, FR: 2025-10-20, DE: 2025-10-17

Condition(s): Dominantly Inherited Alzheimer’s Disease (DIAD)
Product: PiB, Placebo to match LY3372993, Remternetug

Primary endpoint: Stage 1: Defined in each drug-specific appendix; will be an assessment of biomarkers of early-stage disease (e.g., amyloid PET, soluble amyloid, soluble phospho-tau) compared with baseline in each treatment group, Stage 2: If applicable, will be defined in each drug-specific appendix, and will be an assessment of the change in progression of biomarkers representing tau, neurodegenerative, and inflammatory pathobiological events in the disease cascade for temporally different periods of the presymptomatic phases of the disease., Remternetug arm specific Primary end point Stage 1: The primary endpoint will only use data collected from Stage 1, and will be the change from baseline in brain Aβ plaque development as measured by centiloid (CL) [11C]-Pittsburgh compound B (PiB) PET.
Endpoint(s): Stage 1 and Stage 2: • Incidence and severity of TEAEs, o serious TEAEs, o serious drug related TEAEs, o TEAEs leading to discontinuation, o TEAEs resulting in death • ARIA noted by MRI • laboratory parameters • vital signs • ECGs (if done), Biomarker interim analyses may be used for dose-adjustment, remediation, or stopping a study drug arm for efficacy and/or futility. Biomarkers are specified for each drug based on mechanism of action and may include soluble biochemical measures (e.g., Aβ and tau), imaging measures of pathology (e.g., amyloid PET), and AD biomarker changes (e.g., atrophy measured by MRI, and neurodegeneration measured by NfL)., Remternetug arm specific Secondary end point Stage 1: Secondary efficacy endpoints include: • The proportion of participants who are amyloid positive (CL level ≥ 16.3) at the end of Stage 1, • Change in CSF pTau217/Tau217 ratio, • Change in CSF pTau231/Tau231 ratio, and • Change in CSF 3-repeat isoform of MTBR (MTBR-3R)., Remternetug arm specific Secondary end point Stage 2: Odds ratio between the treated group and the external control group (DIAN Obs and DIAN-TU-001 placebo) of being in the lower biomarker disease progression stage based on two-stage modeling of 6 biomarkers (CSF tau phosphorylated tau at residue 153 (pTau153)/Tau153 ratio, CSF pTau205/Tau205 ratio, CSF microtubule binding region of tau 243 amino acids long (MTBR-tau243), MRI hippocampal volume, CSF NfL, and MRI precuneus thickness)., Remternetug arm specific Secondary end point Stage 2: Other secondary endpoints for Stage 2 include: • Fluid and Imaging Biomarker Efficacy Endpoints o CSF pTau217/Tau217 ratio, CSF pTau231/Tau231, CSF MTBR-3R • Clinical and Cognitive Efficacy Endpoints o A cognitive composite derived as an average of these four tests: MAC-Q, Category Fluency (Animals), FCSRT-IR, WAIS-R Digit Symbol Substitution Test, and MMSE. o CDR-SB

Source: https://euclinicaltrials.eu/ctis-public/view/2024-517187-36-01